EU clinical trial 2024-511738-11-00: A MULTICENTER, RANDOMIZED, DOUBLE-BLIND, RISANKIZUMABCONTROLLED, PARALLEL-GROUP STUDY TO EVALUATE THE EFFICACY AND SAFETY OF BIMEKIZUMAB IN ADULT STUDY PARTICIPANTS WITH ACTIVE PSORIATIC ARTHRITIS
Protocol code: PA0016
Sponsor: UCB Biopharma (Pharmaceutical company). Phase: Therapeutic confirmatory (Phase III). Countries: Germany (ended), Poland (ended), Bulgaria (ended), Spain (ended), Hungary (ended), Czechia (ended).
Therapeutic area(s): Diseases [C] - Musculoskeletal Diseases [C05]; Diseases [C] - Skin and Connective Tissue Diseases [C17]; Diseases [C] - Immune System Diseases [C20]
Gender: Female, Male. Age: 18-64 years, 65+ years. Enrolment: 418.
Status: Ended. Start date (EU): 2024-12-18. End date (EU): 2026-05-27. End date: 2026-06-03. Decision date: 2024-11-08. Results received: No. Last updated: 2026-04-20.
Decision dates by country: DE: 2024-11-08, CZ: 2024-11-18, HU: 2024-11-18, PL: 2024-11-18, BG: 2024-11-18, ES: 2024-11-18

Condition(s): Psoriatic arthritis
Product: bimekizumab, Skyrizi 150 mg solution for injection in pre-filled syringe, Placebo matching test and comparator. 0.9% sodium chloride solution for injection (unauthorized).

Primary endpoint: American College of Rheumatology 50 (ACR50) at Week 16
Endpoint(s): • Minimal Disease Activity (MDA) at Week 16, • Composite endpoint composed of ACR50 and Psoriasis Area and Severity Index 100% (PASI100) response at Week 16 in the subgroup of study participants with PSO involving at least 3% body surface area (BSA) at Baseline, • Treatment-emergent adverse events (TEAEs), • Treatment-emergent serious AEs, • TEAEs leading to withdrawal from investigational medicinal product (IMP), • American College of Rheumatology 50 (ACR50) at Week 4

Source: https://euclinicaltrials.eu/ctis-public/view/2024-511738-11-00